EU clinical trial 2023-503467-41-00: A Phase 3 Randomized Study Comparing Talquetamab SC in Combination With Daratumumab SC and Pomalidomide (Tal-DP) or Talquetamab SC in Combination With Daratumumab SC (Tal-D) Versus Daratumumab SC, Pomalidomide and Dexamethasone (DPd), in Participants With Relapsed or Refractory Multiple Myeloma who Have Received at Least 1 Prior Line of Therapy
Protocol code: 64407564MMY3002
Sponsor: Janssen - Cilag International (Pharmaceutical company). Phase: Therapeutic confirmatory (Phase III). Countries: Greece (ongoing, recruitment ended), Poland (ongoing, recruitment ended), Belgium (ongoing, recruitment ended), France (ongoing, recruitment ended), Germany (ongoing, recruitment ended), Czechia (ongoing, recruitment ended), Spain (ongoing, recruitment ended), Netherlands (ongoing, recruitment ended), Italy (ongoing, recruitment ended).
Therapeutic area(s): Diseases [C] - Neoplasms [C04]
Gender: Female, Male. Age: 18-64 years, 65+ years. Enrolment: 310.
Status: Ongoing, recruitment ended. Start date (EU): 2022-10-12. Decision date: 2024-06-28. Results received: No. Last updated: 2026-01-27.
Decision dates by country: BE: 2024-07-03, DE: 2024-07-03, PL: 2024-08-04, GR: 2024-07-22, FR: 2024-07-05, NL: 2024-06-28, CZ: 2024-07-03, ES: 2024-07-03, IT: 2024-07-29

Condition(s): Relapsed or Refractory Multiple Myeloma
Product: Fortecortin® 2 mg Tabletten, Privigen 100 mg/ml solution for infusion, Privigen 100 mg/ml solution for infusion, KIOVIG 100 mg/ml solution for infusion, Imnovid 4 mg hard capsules, Privigen 100 mg/ml solution for infusion, Pomalidomide, KIOVIG 100 mg/ml solution for infusion, Imnovid 1 mg hard capsules, KIOVIG 100 mg/ml solution for infusion, Pomalidomide, Dexamethasone Tablets BP 2.0mg, JNJ-64407564, JNJ-64407564, Pomalidomide, DARZALEX 1800 mg solution for injection, Imnovid 3 mg hard capsules, Dexamethason 4 mg JENAPHARM®, Imnovid 2 mg hard capsules, Pomalidomide

Primary endpoint: Progression-Free Survival

Source: https://euclinicaltrials.eu/ctis-public/view/2023-503467-41-00